EU clinical trial 2024-511953-23-00: A Phase III, Randomized, Double-Blinded, Placebo-Controlled, Multi-Centre Study Evaluating the Safety, Tolerability and Efficacy of Combination Treatment of BL-8040 and G-CSF as Compared to Placebo and G-CSF for the Mobilization of Hematopoietic Stem Cells for Autologous Transplantation in Subjects with Multiple Myeloma – The GENESIS Study
Protocol code: BL-8040.SCM.301
Sponsor: Bioline Rx Ltd. (Pharmaceutical company). Phase: Therapeutic confirmatory (Phase III). Countries: Italy (ongoing, recruitment ended), Spain (ongoing, recruitment ended), Hungary (ongoing, recruitment ended), Germany (ongoing, recruitment ended).
Therapeutic area(s): Diseases [C] - Neoplasms [C04]
Gender: Female, Male. Age: 18-64 years, 65+ years. Enrolment: 44.
Status: Ongoing, recruitment ended. Start date (EU): 2019-05-17. Decision date: 2024-07-18. Results received: No. Last updated: 2026-07-29.
Decision dates by country: ES: 2024-07-18, DE: 2024-07-22, IT: 2024-07-30, HU: 2024-07-18

Condition(s): Hematopoietic Stem Cell mobilization autologous transplantation in Multiple Myeloma
Product: MOTIXAFORTIDE, BL-8040 Placebo is formulated as a sterile and non-pyrogenic lyophilized powder in a vial containing 50 mg of mannitol. BL-8040 Placebo should be administrated SC following reconstitution with 2 mL 0.45% Sodium Chloride for Injection (Half Normal Saline).

Primary endpoint: Efficacy Endpoint: Proportion of subjects mobilizing ≥6.0 x 10^6 CD34+ cells/kg with up to 2 apheresis sessions in preparation for auto-HCT after G-CSF + single administration of BL-8040 or placebo.
Endpoint(s): Efficacy Endpoint: Proportion of subjects who collect ≥2.0 x 10^6 CD34+ cells/kg in 1 apheresis session., Efficacy Endpoint: Proportion of subjects who collect ≥6.0 x 10^6 CD34+ cells/kg in 1 apheresis session., Additional Secondary Efficacy Endpoints: Time from transplantation to neutrophil engraftment, defined as ANC ≥ 0.5 x 10^9/L for 3 consecutive days or ≥1.0 x 10^9/L for 1 day following the conditioning regimen associated nadir., Time from transplantation to platelet engraftment, defined as the first of 3 consecutive measurements of platelet count ≥20 x 10^9/L without platelet transfusion support for 7 days following the conditioning regimen associated nadir., Time from transplantation to engraftment, defined as the time to neutrophils and platelets engraftment, whichever comes later., Graft durability at 60 days post-transplantation., Graft durability at 100 days post-transplantation., Graft durability at 6 months post-transplantation., Graft durability at 9 months post-transplantation., Graft durability at 12 months post-transplantation.

Source: https://euclinicaltrials.eu/ctis-public/view/2024-511953-23-00